EU clinical trial 2022-503165-30-00: CAR123 T cell treatment of relapsed/refractory hematologic malignancies.
Protocol code: UHKT-CAR123-01
Sponsor: Institute Of Hematology And Blood Transfusion (Hospital/Clinic/Other health care facility). Phase: Human Pharmacology (Phase I)- First administration to humans. Countries: Czechia (ongoing, recruiting).
Therapeutic area(s): Diseases [C] - Neoplasms [C04]; Diseases [C] - Hemic and Lymphatic Diseases [C15]
Gender: Female, Male. Age: 65+ years. Enrolment: 18.
Status: Ongoing, recruiting. Start date (EU): 2024-10-23. Decision date: 2024-09-05. Results received: No. Last updated: 2026-05-21.

Condition(s): Relapsed/refractory CD123+ hematological malignancies: Acute Myeloid Leukemia, Myelodysplastic Syndrome, Blastic Plasmacytoid Dendritic Cell Neoplasm, Acute Lymphoblastic Leukemia.

Source: https://euclinicaltrials.eu/ctis-public/view/2022-503165-30-00